EU clinical trial 2023-505469-95-00: Fecal microbiota transplantation for primary sclerosing cholangitis - randomized study versus sham transplantation (FMT-SCLER).
Protocol code: APHP211053
Sponsor: Assistance Publique Hopitaux De Paris (Hospital/Clinic/Other health care facility). Phase: Phase II and Phase III (Integrated). Countries: France (authorised, recruitment pending).
Therapeutic area(s): Diseases [C] - Nutritional and Metabolic Diseases [C18]
Gender: Female, Male. Age: 18-64 years, 65+ years. Enrolment: 72.
Status: Authorised, recruitment pending. Decision date: 2025-12-02. Results received: No. Last updated: 2026-07-24.

Condition(s): Primary Sclerosing Cholangitis
Product: Enema transplant of fecal microbiota, Placebo coloscopic transplant of Fecal microbiota, Placebo double encapsulated oral transplant of fecal microbiota, Double encapsulated oral transplant of fecal microbiota

Primary endpoint: Proportion of success at week 48. Success is defined as patients with serum ALP <1.3 ULN at week 48 and a reduction of, at least 15%, compared to baseline ALP level AND total bilirubin ≤ 1 ULN at week 48
Endpoint(s): Proportion of patients with serum ALP <1.3 ULN and a reduction of at least 15% compared to baseline ALP level at week 12 24 36 and 48, Proportion of patients that normalized total bilirubin at week 12 ,24 36 and 48 (total bilirubin <1 ULN), Proportion of patients that normalized ALP at week 12 24 36 and 48 (ALP <1 ULN), Proportion of patients that normalized all liver tests (ALP <1ULN and GGT <1 ULN and AST <1 ULN and ALT <1 ULN and total bilirubin <1 ULN) at week 12 24 36 and 48, Change in Elastometry between week 0 and week 48, PSC Prognostic scores including the MELD score, the Revised PSC Mayo Risk Score, the Amsterdam-Oxford prognostic model (week 0, week 24, week 48), Safety endpoints: - Percentage of patients with clinical (including infectious events and increased IBD activity) or biological adverse events (leucocytes, CRP) during the study period (overall and between randomization and week 48, between randomization and week 104) - Survival rate without liver events (decompensation of cirrhosis, acute cholangitis, jaundice, need for ERCP) at week 48, Pruritus (VAS and 5D pruritus scale) at week 0, 12, 24, 36 and 48, Symptoms and quality of life (PRO-CSP questionnaire, QMCF questionnaire – Questionnaire de la maladie chronique du foie) and fatigue (PBC 40 questionnaire) : at week 0, week 24 and week 48, Bile acids measured by chromatography at week 0, week 48, Cholangiographic abnormalities, assessed by magnetic resonance cholangiography at week 0, week 48, Changes in IBD activity: clinical score between week 0 and week 48 (HBI and Crohn’s disease Activity Index [CDAI] for Crohn’s disease and Mayo score for Ulcerative colitis), fecal calprotectin and endoscopic score assessed by colonoscopy (Crohn’s disease Endoscopic Index of Severity [CDEIS] for Crohn’s disease and ulcerative colitis Endoscopic Index of Severity [UCEIS] for ulcerative colitis)., Analysis of gut microbiota at week 0, 12, 24, 36 and 48.

Source: https://euclinicaltrials.eu/ctis-public/view/2023-505469-95-00